EU clinical trial 2022-502827-23-00: A Phase 2, Double-Blind, Randomized, 16-Week, Vehicle-Controlled, Efficacy and Safety Study of Ruxolitinib Cream Followed by an Open-Label Extension Period in Adults With Chronic Hand Eczema
Protocol code: INCB 18424-226
Sponsor: Incyte Corp. (Pharmaceutical company). Phase: Therapeutic exploratory (Phase II). Countries: Germany (ended), Poland (ended).
Therapeutic area(s): Diseases [C] - Skin and Connective Tissue Diseases [C17]
Gender: Female, Male. Age: 18-64 years, 65+ years. Enrolment: 51.
Status: Ended. Start date (EU): 2023-10-12. End date (EU): 2024-12-13. End date: 2024-12-13. Decision date: 2023-09-11. Results received: Yes. Last updated: 2024-06-07.
Decision dates by country: PL: 2023-09-18, DE: 2023-09-11

Condition(s): Chronic Hand Eczema
Product: Vehicle Cream: Same formulation of cream as the Test product but without active substance., Ruxolitinib cream

Primary endpoint: Proportion of participants achieving IGA-CHE-TS at Week 16.
Endpoint(s): Proportion of participants achieving ITCH4 response at Week 16, Proportion of participants achieving ITCH4 response at Week 4, Proportion of participants achieving ITCH4 response at Week 1 (Day 7)., Proportion of participants achieving IGA-CHE-TS at each postbaseline visit., Proportion of participants achieving ITCH4 response at Day 3., Change from baseline in CHE-related Itch NRS score at each postbaseline visit., Time to ≥ 4-point improvement from baseline in CHE-related Itch NRS score., Change from baseline in CHE-related Skin Pain NRS score at each postbaseline visit., Proportion of participants achieving ≥ 2-point improvement in CHE related Skin Pain NRS score from baseline to Week 16., Time to ≥ 2-point improvement from baseline in CHE-related Skin Pain NRS score., Percentage change in HECSI from baseline to Week 16., PGIC score at each postbaseline visit., Change from baseline in DLQI score at Weeks 2, 4, 8, 12, 16, 24, and 32., Change from baseline in EQ-5D-5L score at Weeks 2, 4, 8, 12, 16, 24, and 32., Change from baseline in QOLHEQ score at Weeks 2, 4, 8, 12, 16, 24, 32, and follow-up., Change from baseline in WPAI-ChHD score at Weeks 2, 4, 8, 12, 16, 24, 32, and follow-up., The type, frequency, and severity of AEs as well as changes in vital signs and laboratory data for hematology and serum chemistry.

Source: https://euclinicaltrials.eu/ctis-public/view/2022-502827-23-00